EU clinical trial 2025-521349-25-00: A Phase 3, Randomized, Double-Masked, Active-Controlled Trial of a Single Intravitreal Injection of 4D-150 in Adults with Macular Neovascularization Secondary to Age-Related Macular Degeneration (4FRONT-2)
Protocol code: 4D-150-C004
Sponsor: 4d Molecular Therapeutics Inc. (Pharmaceutical company). Phase: Therapeutic confirmatory (Phase III). Countries: Germany (ongoing, recruiting), Italy (ongoing, recruiting), Hungary (ongoing, recruiting), Bulgaria (ongoing, recruiting), Lithuania (ongoing, recruiting), France (ongoing, recruiting), Spain (ongoing, recruiting), Latvia (ongoing, recruiting), Portugal (ongoing, recruiting).
Therapeutic area(s): Diseases [C] - Eye Diseases [C11]
Gender: Female, Male. Age: 18-64 years, 65+ years. Enrolment: 298.
Status: Ongoing, recruiting. Start date (EU): 2025-12-09. Decision date: 2025-11-21. Results received: No. Last updated: 2026-06-22.
Decision dates by country: FR: 2025-11-24, DE: 2025-11-21, LT: 2025-11-21, LV: 2025-11-22, PT: 2025-11-21, HU: 2025-11-24, BG: 2025-11-24, IT: 2025-11-21, ES: 2025-11-21

Condition(s): Macular neovascularization secondary to age-related macular degeneration (nAMD)
Product: Eylea 40 mg/mL solution for injection in pre-filled syringe, 4D-150, Eylea 40 mg/mL solution for injection in pre-filled syringe, Eylea 40 mg/mL solution for injection in pre-filled syringe, DIFLUPREDNATE, Eylea 40 mg/mL solution for injection in pre-filled syringe

Primary endpoint: Mean change from baseline in BCVA ETDRS letter score at Week 52
Endpoint(s): Mean annualized number of aflibercept injections after Week 4 through Weeks 52 and 104, Incidence and timing of aflibercept injections after Week 4 through Weeks 52 and 104, Proportion of subjects not requiring aflibercept injections after Week 4 through Weeks 52 and 104 in the 4D-150 arm, Time to first aflibercept injection after Week 4 in the 4D-150 arm, Mean change from baseline in CST over time through Weeks 52 and 104, Mean change from baseline in BCVA ETDRS letter score over time through Weeks 52 and 104

Source: https://euclinicaltrials.eu/ctis-public/view/2025-521349-25-00